EU clinical trial 2023-508084-76-00: A Phase 2, Double-blind, Randomized, Active-control, Parallel Group Study to Assess the Pharmacokinetics, Pharmacodynamics, Immunogenicity, and safety of SAR447537 (INBRX-101) Compared to Plasma Derived Apha1-Proteinase Inhibitor (A1PI) Augmentation Therapy in Adults with Alpha-1 Antitrypsin Deficiency (AATD) Emphysema
Protocol code: INBRX101-01-201
Sponsor: Sanofi AATD Inc. (Pharmaceutical company). Phase: Therapeutic exploratory (Phase II). Countries: Denmark (ended), Sweden (ended), Ireland (ended), Spain (ended), Poland (ended).
Therapeutic area(s): Diseases [C] - Respiratory Tract Diseases [C08]; Diseases [C] - Congenital, Hereditary, and Neonatal Diseases and Abnormalities [C16]
Gender: Female, Male. Age: 18-64 years, 65+ years. Enrolment: 34.
Status: Ended. Start date (EU): 2024-05-31. End date (EU): 2025-05-28. End date: 2025-08-06. Decision date: 2024-04-24. Results received: Yes. Last updated: 2025-03-27.
Decision dates by country: IE: 2024-04-29, PL: 2024-04-29, DK: 2024-04-24, ES: 2024-04-29, SE: 2024-04-25

Condition(s): Alpha-1 Antitrypsin Deficiency (AATD) Emphysema
Product: Sodium Chloride 0.9%, INBRX-101 Concentrate for Solution for Infusion 50mg/ml, Respreeza 1,000 mg powder and solvent for solution for infusion.

Primary endpoint: Mean change in average fAAT concentration as measured by anti-neutrophil elastase capacity [ANEC] from baseline to average serum trough fAAT concentration at steady state (Ctrough,ss) in participants treated with SAR447537 compared to A1PI
Endpoint(s): 1. Mean change in serum fAAT concentration from baseline to fAAT average concentration at steady state (Cavg,ss) in participants treated with INBRX-101 compared to A1PI 2. Percentage of days with fAAT above the lower limit of the normal range during steady-state dosing in participants treated with INBRX-101 compared to A1PI, 3. Incidence of all treatment emergent adverse events (TEAEs), TEAEs ≥ Grade 3, serious adverse events (SAEs), TEAEs leading to IMP discontinuation, adverse events of special interest (AESI) (including infusion-related reactions), 4. Frequency of anti-drug antibodies (ADA) against SAR447537 and endogenous AAT, as well as neutralizing ADA (NAb) against SAR447537 and endogenous AAT 5. Population PK modeling to assess impact of physiologically relevant patient participants characteristics (eg, covariates including, but not limited to, age, sex, body size, ethnicity) and disease on PK

Source: https://euclinicaltrials.eu/ctis-public/view/2023-508084-76-00